EU clinical trial 2023-509509-62-00: A global multicenter phase 1/2 trial of EO4010, a novel microbial-derived peptide therapeutic vaccine, in combination with nivolumab and/or bevacizumab, for treatment of patients with previously treated metastatic colorectal carcinoma (the "AUDREY" study).
Protocol code: EOCRC2-22
Sponsor: Enterome (Pharmaceutical company). Phase: Phase I and Phase II (Integrated)- First administration to humans. Countries: France (ended), Spain (ended).
Therapeutic area(s): Diseases [C] - Neoplasms [C04]
Gender: Female, Male. Age: 18-64 years, 65+ years. Enrolment: 28.
Status: Ended. Start date (EU): 2023-05-03. End date (EU): 2025-05-29. End date: 2025-05-31. Decision date: 2024-06-28. Results received: Yes. Last updated: 2025-06-11.
Decision dates by country: FR: 2024-07-03, ES: 2024-06-28

Condition(s): Patients with unresectable, previously treated locally advanced or metastatic colorectal carcinoma.
Product: EO4010, OPDIVO 10 mg/mL concentrate for solution for infusion., Zirabev 25 mg/ml concentrate for solution for infusion.

Primary endpoint: The primary endpoint includes safety and tolerability of EO4010 in combination with nivolumab, and/or with bevacizumab by a descriptive medical assessment of the combined profile of incidences of adverse events (AEs), treatment-emergent AEs (TEAEs), serious AEs (SAEs), deaths, reasons for treatment discontinuation/delays, and laboratory abnormalities using the NCI-CTCAE v5.0 grading system.
Endpoint(s): percentage of patients with shown immunogenicity (expansion of specific T cells comparing samples taken at baseline versus on treatment in an individual patient determining if the patient has a positive response to the immunization, or not) in relation to each peptide composing EO4010 by interferon-gamma (IFN-γ) enzyme-linked immunospot (ELISpot), and by intracellular cytokines staining, or multimers staining assays., Cross-reactivities with the human TAAs., ORR, DCR, TTR, DOR and, PFS as described by RECIST 1.1 and iRECIST criteria., OS

Source: https://euclinicaltrials.eu/ctis-public/view/2023-509509-62-00